EU clinical trial 2024-514997-27-00: PULSE : Activity and tolerability of maintenance avelumab immunotherapy after first line polychemotherapy including a platinum salt in patients suffering from locally advanced or metastatic squamous cell penile carcinoma (SPC)
Protocol code: P/2017/337
Sponsor: Centre Hospitalier Regional Universitaire (Hospital/Clinic/Other health care facility). Phase: Therapeutic exploratory (Phase II). Countries: France (ongoing, recruitment ended).
Therapeutic area(s): Diseases [C] - Male Urogenital Diseases [C12]
Gender: Male. Age: 18-64 years, 65+ years. Enrolment: 28.
Status: Ongoing, recruitment ended. Start date (EU): 2025-12-18. Decision date: 2024-12-03. Results received: No. Last updated: 2024-12-03.

Condition(s): cell penile carcinoma
Product: AVELUMAB

Primary endpoint: Disease-free progression (DFS): time period between the date of starting avelumab and the date of first progression (local, remote [measurement of disease according to RECIST v1.1 criteria], second cancer) or death regardless of cause. The patients lost to follow up and patients who are alive without disease progression will be censured at the date of last news.
Endpoint(s): Overall survival (OS) defined as the time period between the date of starting treatment and the date of death, regardless of cause. Patients lost to follow up and those who are alive will be censured at the date of last news., Proportion of patients who are alive at 12 months: number of patients alive at 12 months divided by the number of patients included initially; patients lost to follow up at 12 months will not be included in this analysis and those lost to follow up will be censured at the date of last news., Duration of treatment with avelumab defined as the time between starting avelumab and permanently stopping avelumab regardless of cause. Patients still on treatment with avelumab at the date the data are frozen will be censured, Assessment of DFS and OS of avelumab in patients with a PD-L1 positive tumour. The definition of DFS and OS is the same and the analyses will be performed with the various positivity thresholds for PD-L1. DAKO/AGILENT clone IHC 22C3 will be the clone chosen, The overall safety profile of avelumab will be described from the assessment of toxicity following the CTCAE (Common Terminology Criteria for Adverse Events) criteria, version 4.03., The times to the 1st and 2nd subsequent systemic therapy (TJPTSU; TJDTSU) are defined as the time period between the avelumab start date and the date of starting the 1st or 2nd anticancer treatment administered for SPC after failure of avelumab therapy. Patients who did not receive any subsequent treatment or who have died prior to receiving subsequent treatment will be censured., Duration of administration of the first/subsequent systemic treatment defined as the time interval between starting the first/subsequent systemic therapy and permanently stopping this therapy regardless of cause. Patients still on treatment with first/subsequent systemic therapy at the date the data are frozen will be censured., QoL will be assessed from the EORTC QLQ-C30 and EUROQOL EQ-5D questionnaires at baseline, D1 of each cycle (approximately 4 weeks), on leaving the study and on disease progression (if the study leaving date and date of progression differ by more than 4 weeks)., Survival without deterioration in quality of life (QFS) assessed from the QLQ-C30 questionnaire defined as the time interval between the date of inclusion and first minimum clinically significant difference (MCSD) in the score at inclusion without significant clinical improvement subsequently or death, regardless of cause.

Source: https://euclinicaltrials.eu/ctis-public/view/2024-514997-27-00